EU clinical trial 2025-525025-12-00: A trial comparing how the body absorbs and gets rid of petadeferitrin taken as two different forms in healthy people
Protocol code: Petadeferitrin-BA-01
Sponsor: Pharmacosmos A/S (Pharmaceutical company). Phase: Human Pharmacology (Phase I)- Other. Countries: Netherlands (temporarily halted).
Therapeutic area(s): Diseases [C] - Hemic and Lymphatic Diseases [C15]
Gender: Female, Male. Age: 18-64 years. Enrolment: 18.
Status: Temporarily halted. Start date (EU): 2026-04-10. Decision date: 2026-04-07. Results received: No. Last updated: 2026-07-15.
Decision dates by country: NL: 2026-06-05

Condition(s): Iron overload from thalassemia, transfusion-dependent myelodysplastic syndromea and haemolysis

Source: https://euclinicaltrials.eu/ctis-public/view/2025-525025-12-00